EU clinical trial 2023-508440-21-00: Temocillin versus meropenem for the targeted treatment of bacteraemia due to third-generation cephalosporin-resistant Enterobacterales (ASTARTÉ):randomised, pragmatic trial
Protocol code: ASTARTÉ
Sponsor: Fundacion Publica Andaluza Para La Gestion De La Investigacion En Salud De Sevilla (Laboratory/Research/Testing facility). Phase: Therapeutic confirmatory (Phase III). Countries: Spain (ended).
Therapeutic area(s): Diseases [C] - Bacterial Infections and Mycoses [C01]
Gender: Female, Male. Age: 18-64 years, 65+ years. Enrolment: 334.
Status: Ended. Start date (EU): 2024-05-21. End date (EU): 2024-12-26. Decision date: 2024-05-21. Results received: Yes. Last updated: 2024-10-01.

Condition(s): Infections due to Enterobacteriaceae
Product: MEROPENEM, TEMOCILLIN, ERTAPENEM

Primary endpoint: A composite endpoint "success" will be used, including: (a) clinical success at test of cure (TOC); (b) alive at day 28; (c) no need to stop or change the assigned drug because of adverse event, perceived failure during treatment or occurrence of a superimposed infection; (d) no need to prolong therapy beyond 14 days; (e) Absence of recurrence up to day 28.
Endpoint(s): 28-day mortality, Length of hospital stay and therapy (IV and total), Appearance of adverse events (frequency and severity)., Resistance development during therapy, Development of superimposed infections., Recurrence rate (recurrences and reinfections) until day 28., Change in SOFA score, In patients over 70 years of age: changes in the Barthel scales, Exploratory variables (carried out only at the coordinating center): serum temocillin levels, temocillin MIC in Enterobacterales according to resistance mechanisms to third-generation cephalosporins., Exposure variables: age, sex, Charlson, underlying chronic conditions, type of acquisition, presence of venous and urinary catheters, mechanical ventilation, surgery previous month, bacteremia focus, Pitt score, presence of sepsis, SOFA prior to initiation of study treatment, mortality risk scale INCREMENT ESBL, empirical therapy (active in vitro or not), hours until administration of first active drug, hours until administration of first study drug, focus control and support therapy.

Source: https://euclinicaltrials.eu/ctis-public/view/2023-508440-21-00